EU clinical trial 2023-504191-26-00: DICIT: Efficacy of diclofenac added to an approved, ongoing PD-1 inhibitor therapy that achieved stable disease as best response in metastatic melanoma patients. A single arm phase II trial
Protocol code: DICIT
Sponsor: Universitaetsklinikum Regensburg (Hospital/Clinic/Other health care facility). Phase: Phase II and Phase III (Integrated). Countries: Germany (ongoing, recruiting).
Therapeutic area(s): Diseases [C] - Neoplasms [C04]; Diseases [C] - Skin and Connective Tissue Diseases [C17]
Gender: Female, Male. Age: 18-64 years, 65+ years. Enrolment: 48.
Status: Ongoing, recruiting. Start date (EU): 2024-08-23. Decision date: 2024-02-05. Results received: No. Last updated: 2026-04-16.

Condition(s): Metastatic Melanoma
Product: NIVOLUMAB, PEMBROLIZUMAB, Diclofenac AL 25 Diclofenac-Natrium 25 mg pro magensaftresistente Tablette, Pantoprazol TAD® 20 mg magensaftresistente Tabletten, Diclo 50 - 1 A Pharma 50 mg magensaftresistente Tabletten

Primary endpoint: Objective response (OR) at week 9 (visit3/day64+5days), defined as a confirmed best response of either a complete response (CR) or a partial response (PR), as determined by investigator assessment using positron emission tomography in combination with computed tomography with contrast agent (diagnostic-quality PET-CT) according to the Response Evaluation Criteria in Solid Tumor, version 1.1 (RECIST 1.1.).

Source: https://euclinicaltrials.eu/ctis-public/view/2023-504191-26-00